EU clinical trial 2024-510584-37-00: A Phase 2, Multicenter, Randomized, Double-Blind, Placebo-Controlled Study to Evaluate the Efficacy and Safety of Obexelimab in Patients With Systemic Lupus Erythematosus
Protocol code: ZB012-02-001
Sponsor: Zenas Biopharma (USA) LLC (Pharmaceutical company). Phase: Therapeutic exploratory (Phase II). Countries: Spain (ongoing, recruitment ended), Poland (ongoing, recruitment ended), Denmark (ongoing, recruitment ended), Bulgaria (ongoing, recruitment ended), Portugal (ongoing, recruitment ended), Italy (ongoing, recruitment ended), Romania (ongoing, recruitment ended), Greece (ongoing, recruitment ended), Germany (ongoing, recruitment ended), Belgium (ongoing, recruitment ended).
Therapeutic area(s): Diseases [C] - Immune System Diseases [C20]
Gender: Female, Male. Age: 18-64 years, 65+ years. Enrolment: 91.
Status: Ongoing, recruitment ended. Start date (EU): 2024-10-22. Decision date: 2024-10-07. Results received: No. Last updated: 2026-07-13.
Decision dates by country: ES: 2024-10-08, PL: 2024-10-13, GR: 2024-10-11, IT: 2024-10-14, DE: 2024-10-10, PT: 2024-10-08, BG: 2024-10-14, BE: 2024-10-08, DK: 2024-10-07, RO: 2024-10-11

Condition(s): Systemic Lupus Erythematosus
Product: PREDNISOLONE, Placebo sterile solution for SC injection, Obexelimab

Primary endpoint: Proportion of patients who achieve a response at Week 24, defined according to the BILAGBased Composite Lupus Assessment (BICLA) Response
Endpoint(s): Proportion of patients who achieve response according to the Systemic Lupus Erythematosus Responder Index 4 (SRI-4) at Week 24, Proportion of patients who achieve Lupus Low Disease Activity State (LLDAS) at Week 24., Time to flare, Proportion of patients achieving prednisone equivalent dose ≤ 5 mg/day by the Week 12 visit and maintained through Week 24 with no disease worsening, Proportion of patients who achieve a ≥ 50% improvement from baseline in Cutaneous Lupus Erythematosus Disease Area and Severity Index Activity (CLASI-A) score (CLASI-50 response) at Week 24 compared with baseline, Proportion of patients who achieve ≥ 50% decrease in active joint count (Joint-50 response) at Week 24 compared with baseline, Change from Baseline in Functional Assessment of Chronic Illness Therapy (FACIT)-Fatigue score at Week 24

Source: https://euclinicaltrials.eu/ctis-public/view/2024-510584-37-00